EU clinical trial 2024-517115-70-00: Platelet inhibition versus direct oral anticoagulation in patients undergoing percutaneous closure of patent foramen ovale or atrial septal defect
Protocol code: NL79578.100.21
Sponsor: Sint Antonius Ziekenhuis Stichting (Hospital/Clinic/Other health care facility). Phase: Therapeutic exploratory (Phase II). Countries: Netherlands (authorised, recruiting).
Therapeutic area(s): Diseases [C] - Cardiovascular Diseases [C14]
Gender: Female, Male. Age: 18-64 years, 65+ years. Enrolment: 52.
Status: Authorised, recruiting. Start date (EU): 2022-05-04. Decision date: 2024-08-15. Results received: No. Last updated: 2024-08-15.

Condition(s): Patent foramen ovale or atrial septum defect
Product: Xarelto 20 mg film-coated tablets, Plavix 75 mg film-coated tablets, ACETYLSALICYLIC ACID

Primary endpoint: This study will capture the following hemostatic endpoints: • Coagulation activation (e.g. prothrombin fragment 1+2, thrombin antithrombin III complex) • Platelet activation (e.g. P-selectin, CD40 ligand) • Von Willebrand Factor Antigen (VWF Ag) • Beta-thrombglobulin (beta-TG) • Plasminogen activator inhibitor-1 (PAI-1) • D-dimer • Thrombin Generation Test • Anti Xa activity

Source: https://euclinicaltrials.eu/ctis-public/view/2024-517115-70-00